EU clinical trial 2024-512287-54-00: A double blinded, phase II, placebo controlled, single centre randomized clinical trial to evaluate Metformin compared with placebo for reversal of accelerated biological aging in persons living with HIV 50 years or older and with suppressed virologic replication.
Sponsor: Fundacion Para La Investigacion Biomedica Del Hospital Universitario La Paz (Patient organisation/association). Phase: Phase I and Phase II (Integrated)- Bioequivalence Study. Countries: Spain (ongoing, recruitment ended).
Therapeutic area(s): Diseases [C] - Virus Diseases [C02]
Gender: Female, Male. Age: 18-64 years, 65+ years. Enrolment: 80.
Status: Ongoing, recruitment ended. Start date (EU): 2021-12-03. Decision date: 2024-03-11. Results received: No. Last updated: 2024-03-11.

Condition(s): HIV infection
Product: Metformina Pensa Pharma 850 mg comprimidos recubiertos con película EFG

Primary endpoint: EAA difference by Phenoage epigenetic clock
Endpoint(s): EAA difference by Horvath´s clock, Hannum´s clock, GrimAge and PhenoAge, Immune profile: % and absolute number of CD4+ T cells, CD8+ T cells, CD4+/CD8+ ratio, haematopoietic progenitors, CD4+ and CD8+ T-cell subsets (recent thymic emigrants, naïve, central and effector memory, TEMRA, activated, exhausted and senescent), T-reg, B-cell subsets (naïve, class-switched memory, non-class switched memory), NK subsets (CD56dim CD16hi, CD56hi CD16-/low) and monocytes (classic, non-classic and intermediate), Changes in the inflammatory markers: IL-6, CRP, D-Dimer, Changes in Telomere length in PBMC, Changes in the following aging biomarkers: • TAME biomarkers: IL-6, TNFR II, hsCRP, GDF15, IGF-1, fasting insulin, cystatin C; NT-proBNP, haemoglobin A1c. Oxidative stress and DNA damage: reactive oxygen species (ROS), catalase expression, superoxide dismutase 1 - 2 levels, γH2AX histone levels. Other inflammatory and pro-coagulant biomarkers: IL-1 beta, TNF-alfa, D-dimer, Changes in the following Frailty battery: Fried frailty index, grip strength, walking speed and short physical performance battery, Changes in creatinine, Changes in integrated and total (Gag) HIV-DNA. Changes in CA US HIV-RNA. Changes in intact proviral DNA

Source: https://euclinicaltrials.eu/ctis-public/view/2024-512287-54-00